EU clinical trial 2023-505804-42-00: B7981041: A PHASE 3 RANDOMIZED WITHDRAWAL AND DOSE-UP TITRATION, MULTICENTER EXTENSION STUDY INVESTIGATING THE SAFETY, EFFICACY, AND TOLERABILITY OF RITLECITINIB IN ADULT AND ADOLESCENT PARTICIPANTS WITH NONSEGMENTAL VITILIGO
Protocol code: B7981041
Sponsor: Pfizer Inc. (Pharmaceutical company). Phase: Therapeutic confirmatory (Phase III). Countries: Poland (ongoing, recruitment ended), Italy (ended), Bulgaria (ended), Spain (ended), Germany (ongoing, recruitment ended).
Therapeutic area(s): Not possible to specify
Gender: Female, Male. Age: 0-17 years, 18-64 years, 65+ years. Enrolment: 137.
Start date (EU): 2024-07-10. Decision date: 2024-04-29. Results received: No. Last updated: 2026-03-06.
Decision dates by country: IT: 2024-06-12, ES: 2024-04-30, PL: 2024-05-06, DE: 2024-04-29, BG: 2024-06-12

Condition(s): NON SEGMENTAL VITILIGO
Product: Capsule to match PF-06651600 (Ritlecitinib) 50 mg, Ritlecitinib tosilate, DEXAMETHASONE, Capsule to match pf-06651600 (ritlecitinib) 100 mg, Ritlecitinib Tosilate

Primary endpoint: Incidence of TEAEs, SAEs, and AEs leading to discontinuation, Incidence of clinically significant laboratory abnormalities.
Endpoint(s): Response based on T-VASI75 (defined as at least 75% improvement in T-VASI from Study B7981040 BL) at all time points in the SoA, Response based on F-VASI75 (defined as at least 75% improvement in F-VASI from Study B7981040 BL) at all time points in the SoA, Response based on T-VASI50 (defined as at least 50% improvement in T-VASI from Study B7981040 BL) at all time points in the SoA, Percent Change from Study B7981040 BL in F-VASI at all time points in the SoA, Percent Change from Study B7981040 BL in T-VASI at all time points in the SoA, Response based on stabilization of disease at all time points after Week 8, defined as: <15-point increase in T-VASI from Study B7981040 Baseline (based on twice the magnitude of the smallest detectable change of 7.1 points in T-VASI) [38]; AND meeting all other criteria for stability, Response based on F-VASI50 (defined as at least 50% improvement in F-VASI from Study B7981040 BL) at all time points in the SoA, Response based on F-VASI90 (defined as at least 90% improvement in F-VASI from Study B7981040 BL) at all time points in the SoA, Response based on F-VASI100 (defined as 100% improvement in F-VASI from Study B7981040 BL) at all time points in the SoA, Response based on T-VASI90 (defined as at least 90% improvement in T-VASI from Study B7981040 BL) at all time points in the SoA, Response based on T-VASI100 (defined as 100% improvement in T-VASI from Study B7981040 BL) at all time points in the SoA, Response based on improvement in Patient Global Impression of Severity – Face (PGISF) at all time points in SoA, Response based on improvement in PGIS-V at all time points in the SoA, Response based on scoring at least “moderately better” on PGIC-F at all time points in the SoA, Response based on scoring at least “moderately better” on PGIC-V at all time points in the SoA

Source: https://euclinicaltrials.eu/ctis-public/view/2023-505804-42-00